EU clinical trial 2024-511945-20-00: Continued PD-L1 inhibition with atezolizumab with rechallenge chemotherapy in patients with sensitive relapse SCLC progressing on first-line platinum-etoposide chemotherapy and a PD-L1 inhibitor: CARRY-ON study - GOIRC-01-2023
Protocol code: GOIRC-01-2023
Sponsor: G.O.I.R.C. Gruppo Oncologico Italiano Di Ricerca Clinica (Patient organisation/association). Phase: Therapeutic exploratory (Phase II). Countries: Italy (ongoing, recruiting).
Therapeutic area(s): Diseases [C] - Neoplasms [C04]
Gender: Female, Male. Age: 18-64 years, 65+ years. Enrolment: 142.
Status: Ongoing, recruiting. Start date (EU): 2025-01-24. Decision date: 2024-09-17. Results received: No. Last updated: 2025-11-26.

Condition(s): patients affected by small cell lung cancer (SCLC)
Product: Tecentriq 1 200 mg concentrate for solution for infusion

Primary endpoint: overall survival (OS), defined as the time from the date of enrollment registration to the date of death from any cause. Patients still alive at the time of analysis are censored at the last time they are known to be alive.
Endpoint(s): Toxicity: the assessment of safety will be based mainly on the frequency of adverse events; toxicity will be measured according to NCI Common Toxicity Criteria Adverse Event (CTCAE), version 5.0., Progression Free Survival (PFS) defined as the time from the patient enrollment registration to the evidence of progressive disease, or death, or the last date the patient was known to be progression-free or alive., Objective response rate (ORR): the sum of RECIST v1.1-defined CR and PR out of the number of assessable patients with measurable disease at baseline.

Source: https://euclinicaltrials.eu/ctis-public/view/2024-511945-20-00